EU clinical trial 2024-518516-39-00: Efficacy and safety of allogenic cultured Adipose-derived mesenchymal stromal cell injections on MoUth fibrosis and handicap in patients with Systemic sclEroderma
Protocol code: RC31/22/0258
Sponsor: Centre Hospitalier Universitaire De Toulouse (Hospital/Clinic/Other health care facility). Phase: Therapeutic exploratory (Phase II). Countries: France (authorised, recruitment pending).
Therapeutic area(s): Diseases [C] - Skin and Connective Tissue Diseases [C17]
Gender: Female, Male. Age: 18-64 years, 65+ years. Enrolment: 50.
Status: Authorised, recruitment pending. Decision date: 2025-08-01. Results received: No. Last updated: 2025-08-01.

Condition(s): Systemic sclEroderma
Product: CHLORURE DE SODIUM PROAMP 0,9 %, solution injectable, CellReady, ALBUMIN

Primary endpoint: the change in the Mouth Handicap in Systemic Sclerosis scale (MHISS) between baseline and week 12; An improvement of at least 5 points will be considered clinically significant
Endpoint(s): The safety throughout the course of the study (until week 24 since baseline) will be assessed by monitoring adverse events, serious adverse events and injection site reactions, Change in maximum interincisal distance and mouth perimeter, Change in Opening, Dryness and Aesthetic of the 3 subscales of the MHISS;, Change in patient-reported outcomes (patient satisfaction assessment (the patients will be asked to fill in a simple questionnaire where their degree of satisfaction could be expressed by a semiquantitative score (unsatisfied, mildly/moderately satisfied, rather satisfied, and very satisfied), sHAQ, OHAT, BOFA questionnaire and EQ-5D-5L at W4, W12 and W24;, Change in oral habits and hygiene measured by oral health and hygiene questionnaire at W24, Change in oral microbiota (only at Toulouse) at W12 and 24, Change in Plaque index (reflecting the ability to maintain oral hygiene) at W12 an W24 (only at Toulouse),, Change in DMFT (decayed missing filled teeth) and Panoramic x-ray at W24;, Change in mandibular tracking (only at Toulouse at W4, W12 and W24 and articular and neuro-muscular activity (only at Toulouse) at W12 and W24, Change posture by stabilometry (only at Toulouse) at W12 and W24, Change in psycho-social aspects and oro-facial pains by EDAS21, Epworth at W4, W12 and W24 and Combadazou-Destruhaut questionnaire (only at Toulouse) at W12 and W24 and drawings of consciousness (only at Toulouse) at W24, Change in modified Rodnan skin score at W12 and W24;, Change in dry mouth syndrome at W4, W12 and W24 (Change in Xerostomia Inventory questionnaire; Change in Salivary flow; Change in the salivary pH, Change in Standardised two-dimensional photographs or facial scan at Toulouse at W4,12 and 24, Change in immunomonitoring of vascular and antifibrotic biomarkers expression at W12;, Not an evaluation criterion but the creation of a serum, plasma biobank at baseline, W12 and W24)., Not an evaluation criterion but the creation of oral microbiota biobank (only at Toulouse at W12 and W24)

Source: https://euclinicaltrials.eu/ctis-public/view/2024-518516-39-00